EU clinical trial 2023-507227-36-00: A Phase 3, Randomized, Placebo-Controlled, Double Blind Clinical Study to Evaluate the Efficacy and Safety of Molnupiravir (MK-4482) in Non-Hospitalized Adults with COVID-19 at High Risk for Disease Progression
Protocol code: MK-4482-023
Sponsor: Merck Sharp & Dohme LLC (Pharmaceutical company). Phase: Therapeutic confirmatory (Phase III). Countries: Italy (ongoing, recruiting), Poland (ongoing, recruiting), Spain (ongoing, recruiting), Finland (ongoing, recruiting), Germany (ongoing, recruiting), Romania (ongoing, recruiting), France (ongoing, recruiting), Bulgaria (ongoing, recruiting).
Therapeutic area(s): Diseases [C] - Virus Diseases [C02]
Gender: Female, Male. Age: 18-64 years, 65+ years. Enrolment: 767.
Status: Ongoing, recruiting. Start date (EU): 2025-02-21. Decision date: 2025-02-06. Results received: No. Last updated: 2026-07-02.
Decision dates by country: FI: 2025-02-07, FR: 2025-04-16, ES: 2025-04-11, DE: 2025-04-10, IT: 2025-02-07, BG: 2025-02-10, RO: 2025-02-11, PL: 2025-02-11

Condition(s): SARS-CoV-2 (COVID-19) infection
Product: Molnupiravir Matching placebo tablets, molnupiravir

Primary endpoint: Percentage of Participants Who Experienced One or More of following through Day 29: Hospitalization, All-cause Mortality, or COVID-19 Related Medically Attended Visit (MAV), Percentage of Participants Who Experienced an Adverse Event (AE), Percentage of Participants Who Discontinued Study Intervention Due to AE
Endpoint(s): Time to Sustained Alleviation (without relapse) of all selected 8 (5 prespecified and 3 determined by baseline prevalence), self-reported COVID-19 signs/symptoms, Change From Baseline in SARS-CoV-2 RNA titer, Percentage of Participants With Undetectable SARS-CoV-2 RNA, Percentage of Participants Who Experienced One or More of following through Day 29: All-cause Hospitalization or All-cause Mortality, Percentage of Participants With Clinically Important Medical Interventions Associated with COVID-19 related MAV or COVID-19 related hospitalization through Day 29, Time to Sustained Alleviation (without relapse) of all 15 self-reported COVID-19 signs/symptoms through Day 29, Time to Sustained Resolution Without Relapse of all 8 (5 prespecified and 3 determined by baseline prevalence) self-reported COVID-19 signs/symptoms through Day 29

Source: https://euclinicaltrials.eu/ctis-public/view/2023-507227-36-00